EU clinical trial 2022-502529-17-00: A Phase 3, randomised, double-blind, parallel-group, 76-week, efficacy and safety study of BI 456906 administered subcutaneously compared with placebo in participants with overweight or obesity without type 2 diabetes
Protocol code: 1404-0038
Sponsor: Boehringer Ingelheim International GmbH, Boehringer Ingelheim RCV GmbH & Co. KG (Pharmaceutical company). Phase: Therapeutic confirmatory (Phase III). Countries: Germany (ended), Netherlands (ended), Sweden (ended), Poland (ended), Finland (ended), Belgium (ended).
Therapeutic area(s): Diseases [C] - Nutritional and Metabolic Diseases [C18]
Gender: Female, Male. Age: 18-64 years, 65+ years. Enrolment: 130.
Status: Ended. Start date (EU): 2024-01-18. End date (EU): 2025-12-19. End date: 2026-02-20. Decision date: 2024-01-15. Results received: No. Last updated: 2025-11-13.
Decision dates by country: SE: 2024-01-18, NL: 2024-01-15, FI: 2024-05-17, DE: 2024-01-15, BE: 2024-06-12, PL: 2024-05-21

Condition(s): Obesity
Product: BI 456906, BI 456906, BI 456906, BI 456906, BI 456906, BI 456906, BI 456906, Placebo

Primary endpoint: Percentage change in body weight from baseline to Week 76, Achievement of body weight reduction ≥5% (yes/no) from baseline to Week 76
Endpoint(s): Achievement of body weight reduction ≥10% (yes/no) from baseline to Week 76, Achievement of body weight reduction ≥15% (yes/no) from baseline to Week 76, Achievement of body weight reduction ≥20% (yes/no) from baseline to Week 76, Absolute change from baseline to Week 76 in: o Body weight (kg) o Waist circumference (cm) o Systolic blood pressure (SBP) (mmHg) o “Capacity to Resist” domain score of the Eating Behaviour PRO (units on scale) o Eating Behaviour PRO total score (units on scale)

Source: https://euclinicaltrials.eu/ctis-public/view/2022-502529-17-00